EU clinical trial 2023-503209-13-00: Co-administration of Acetaminophen with Ibuprofen to Improve Duct-Related Outcomes in Extremely Premature Infants – The ACEDUCT Trial
Sponsor: Royal College Of Surgeons In Ireland (Educational Institution). Phase: Therapeutic exploratory (Phase II). Countries: Ireland (ended).
Therapeutic area(s): Diseases [C] - Cardiovascular Diseases [C14]
Gender: Female, Male. Age: 0-17 years. Enrolment: 75.
Status: Ended. Start date (EU): 2024-08-07. End date (EU): 2026-02-06. Decision date: 2023-07-28. Results received: No. Last updated: 2025-09-02.

Condition(s): Patent ductus arteriosus (PDA)
Product: Sodium Chloride 0.9% w/v Intravenous Infusion BP Solution for Infusion, Paracetamol 10mg/ml solution for infusion, Pedea 5 mg/ml solution for injection

Primary endpoint: Primary outcome: Composite of pre-discharge mortality or any grade BPD, defined as need for oxygen or positive pressure respiratory support at 36 weeks postmenstrual age.
Endpoint(s): i) PDA treatment success, defined as PDA closure or becoming insignificant [diameter <1.5 mm]. ii) Renal or hepatic dysfunction occurring within 7 days of treatment initiation, as defined under exclusion criteria. iii) Further exposure to PDA treatments (these will be as per units’ standard practice, not part of this study). iv) Procedure for PDA closure. v)Mortality, vi) severity of BPD at 36 weeks postmenstrual age using Jensen’s criteria recently shown to be the definition which best predicted early childhood morbidities (grade 1, nasal cannula ≤2 L/min; grade 2, nasal cannula >2 L/min or noninvasive positive airway pressure; grade 3, invasive mechanical ventilation), vii) NEC ≥ stage 2A. viii) Duration (days) of invasive or non-invasive respiratory support. ix) Diuretic use during NICU stay. x) Exposure to postnatal steroids. xi) Sepsis during NICU stay

Source: https://euclinicaltrials.eu/ctis-public/view/2023-503209-13-00